EU clinical trial 2025-525013-23-00: A Global, Multicenter, Randomized, Double-Blind, Placebo-Controlled, Phase 2/3 Study of EIK1001 in Combination with Pembrolizumab and Chemotherapy in Participants with Stage 4 Non-Small Cell Lung Cancer (TeLuRide-008).
Protocol code: EIK1001-008
Sponsor: Eikon Therapeutics Inc. (Pharmaceutical company). Phase: Therapeutic exploratory (Phase II). Countries: Germany (authorised, recruitment pending), Spain (ongoing, recruiting), Netherlands (authorised, recruitment pending), Romania (authorised, recruitment pending), Greece (authorised, recruitment pending), Italy (authorised, recruitment pending).
Therapeutic area(s): Diseases [C] - Neoplasms [C04]
Gender: Female, Male. Age: 18-64 years, 65+ years. Enrolment: 115.
Start date (EU): 2026-07-09. Decision date: 2026-05-21. Results received: No. Last updated: 2026-07-29.
Decision dates by country: RO: 2026-06-02, IT: 2026-05-22, NL: 2026-05-28, DE: 2026-05-27, GR: 2026-05-21, ES: 2026-06-01

Condition(s): Stage 4 (IV) Non-Small Cell Lung Cancer (NSCLC)
Product: EIK1001 solution for injection 1.0 mg/mL free base equivalent, Inactive control which is identical in appearance and composition as EIK1001 drug product except for the lack of EIK1001 drug substance, PEMBROLIZUMAB

Primary endpoint: 1. PFS defined as the time from randomization to documented progressive disease per RECIST 1.1 by BICR or death due to any cause, whichever occurs first., 2. OS defined as the time from randomization to death due to any cause Objective Response (OR; defined as participants who demonstrate CR or PR by RECIST 1.1 as assessed by the Investigator), AEs, and discontinuation of study intervention due to an AE (Dose Optimization Only)
Endpoint(s): 1. Objective Response (OR) defined as participants who demonstrate confirmed CR or PR according to RECIST 1.1 by BICR, 2. DOR defined as the time from the first document edevidence of CR or PR until disease progression or death due to any cause, whichever occurs first, according to RECIST 1.1 by BICR, 3. PFS, OR, and DOR according to RECIST 1.1 by Investigator, 4. AEs and discontinuation of study intervention due to any AE

Source: https://euclinicaltrials.eu/ctis-public/view/2025-525013-23-00